EU clinical trial 2025-523781-25-00: PHASE 1 STUDY TO EVALUATE THE SAFETY, TOLERABILITY AND IMMUNOGENICITY OF E-VIM VACCINE CVX1 WITH OR WITHOUT ICI IN THE TREATMENT OF SUBJECTS WITH MUSCLE INVASIVE BLADDER CANCER (MIBC) OR LOCALIZED OR LOCALLY ADVANCED RENAL CELL CANCER (RCC).
Protocol code: CC-CVx1-001
Sponsor: CimCure B.V. (Pharmaceutical company). Phase: Human Pharmacology (Phase I)- First administration to humans. Countries: Netherlands (ongoing, recruiting).
Therapeutic area(s): Diseases [C] - Neoplasms [C04]
Gender: Female, Male. Age: 18-64 years, 65+ years. Enrolment: 83.
Status: Ongoing, recruiting. Start date (EU): 2026-04-02. Decision date: 2026-01-29. Results received: No. Last updated: 2026-04-14.

Condition(s): metastatic solid cancer, muscle invasive bladder cancer, localized or locally advanced renal cell cancer (RCC)

Source: https://euclinicaltrials.eu/ctis-public/view/2025-523781-25-00